EU clinical trial 2025-521839-36-00: Phase II study of Cemiplimab before and after standard chemoradiotherapy for patients with locally advanced cervical carcinoma. CADILLACC TRIAL
Protocol code: CADILLACC TRIAL
Sponsor: Fondazione IRCCS Istituto Nazionale Dei Tumori (Hospital/Clinic/Other health care facility). Phase: Therapeutic exploratory (Phase II). Countries: Italy (authorised, recruitment pending).
Therapeutic area(s): Diseases [C] - Female Urogenital Diseases and Pregnancy Complications [C13]
Gender: Female. Age: 18-64 years. Enrolment: 29.
Status: Authorised, recruitment pending. Decision date: 2026-02-06. Results received: No. Last updated: 2026-02-06.

Condition(s): locally advanced cervical carcinoma
Product: CISPLATINO SANDOZ, LIBTAYO 350 mg concentrate for solution for infusion.

Primary endpoint: The primary endpoint is the objective response rate (ORR), defined as the percentage of the participants who achieve a complete response (CR) or partial response (PR) RECIST 1.1
Endpoint(s): Progression-free survival (PFS): is defined as the time from date of enrollment until RECIST 1.1-defined radiological progression or histopathologically confirmed progression as assessed by the Investigator or death due to any cause, whichever occurs earlier, Progression-free survival (PFS) in participants with PD-L1 high expression: defined as the time from date of of enrollment until RECIST 1.1-defined radiological progression or histopathologically confirmed progression as assessed by the Investigator or death due to any cause, whichever occurs earlier, Progression-free survival rate at 2and 3 years: defined as the proportion of participants that are progression-free survival event-free at 2 and 3 years, Progression-free survival at 2 and 3 years in participants with PD-L1 high expression: defined as the proportion of participants that are progression-free survival event-free at 2 and 3 years, Overall Survival (OS): defined as time from enrollment until the date of death due to any cause, OS in participants with PD-L1 high expression: defined as time from randomization until the date of death due to any cause, ORR in participants with PD-L1 high expression: defined as the proportion of participants who have a CR or PR, as determined by Investigator per RECIST 1.1, Duration of Response (DoR) in participants with a CR or PR: defined as the time from date of first detection of CR or PR until the date of RECIST 1.1-defined radiological progression or histopathologically confirmed progression, DoR in participants with PD-L1 high expression: defined as the DoR in participants with a CR or PR: Time from date of first detection of CR or PR until the date of RECIST 1.1-defined radiological progression or histopathologically confirmed progression, PFS2: defined as the time from enrollment to the earliest of the progression event (following the initial Investigator-assessed progression), after first subsequent therapy, or death. The date of second progression will be recorded by the Investigator in the eCRF and defined according to local standard clinical practice, TFST: defined as the time from enrollment until the start date of the first subsequent anti-cancer therapy after discontinuation of randomized treatment, or death due to any cause, Incidence of Local Progression, and DistaDisease Progression: Number and percentage of participants who develop local progression, distant disease recurrence, Percentage of patients with treatment emergent adverse events as defined by CTCAE v.5.0, Maximum grade of each adverse event as defined by CTCAE v.5.0 by patient, Study treatment discontinuation due to adverse events, Description of change from baseline in European Organization for Research and Treatment of Cancer Quality of Life Questionnaire EORTC QLQ-C30 Global Score and Physical Function subscale, Description of change from baseline in The European Organization for Research and Treatment of Cancer Quality of Life Questionnaire (Symptom Score for Cervical Cancer) EORTC QLQ-CX24 symptom specific scale, Description of change from baseline Visual Analog Scale and utilities will be assessed using the European Quality of Life EQ-5D-5L, Proportion of patient achiving complete pathological response defined at the end of induction phase and at the end of maintenance treatment. Complete pathological responses will be defined as follows: complete disappearance of tumor in the cervix biopsy, Description of molecular biomarkers that may be indicative of clinical response/resistance, safety, and/or the mechanism of action of cemiplimab

Source: https://euclinicaltrials.eu/ctis-public/view/2025-521839-36-00